EU clinical trial 2023-508073-87-00: A phase Ib/II open-label, multi-center dose escalation study of JDQ443 in patients with advanced solid tumors harboring the KRAS G12C mutation
Protocol code: CJDQ443A12101
Sponsor: Novartis Pharma AG (Pharmaceutical company). Phase: Phase I and Phase II (Integrated)- First administration to humans. Countries: Netherlands (ended), Spain (ongoing, recruitment ended), Germany (ongoing, recruitment ended), France (ongoing, recruitment ended), Belgium (ongoing, recruitment ended), Italy (ongoing, recruitment ended), Denmark (ongoing, recruitment ended).
Therapeutic area(s): Diseases [C] - Neoplasms [C04]
Gender: Female, Male. Age: 18-64 years, 65+ years. Enrolment: 359.
Start date (EU): 2024-11-14. Decision date: 2024-09-02. Results received: No. Last updated: 2026-05-13.
Decision dates by country: DE: 2024-09-02, NL: 2024-09-02, BE: 2024-09-02, ES: 2024-09-09, IT: 2024-09-23, FR: 2024-09-03, DK: 2024-09-10

Condition(s): Advance solid tumors harboring the KRAS G12C mutation
Product: TNO155, JDQ443, TNO155, VDT482/ BGB-A317, JDQ443, TNO155, TNO155

Primary endpoint: Dose Escalation: - Safety: Incidence and severity of dose limiting toxicities (DLTs) during the first cycle of monotherapy or combination treatment during the dose escalation part. Incidence and severity of adverse events (AEs) and serious adverse events (SAEs), including changes in laboratory values, electrocardiograms (ECGs), and vital signs by treatment, Dose Escalation: - Tolerability: Frequency of dose interruptions, reductions, and dose intensity, by treatment, Dose Expansion: - ORR per RECIST 1.1 (all groups except the brain metastasis group), Dose Expansion: - OIRR per mRANO-BM (brain metastasis group only), Dose Expansion: - Safety: Incidence and severity of AEs and SAEs, including changes in laboratory values, ECGs, and vital signs, Dose Expansion: - Tolerability: Frequency of dose interruptions, reductions, and dose intensity, Dose Expansion: - Efficacy: ORR* per RECIST 1.1 (JDQ443 dose randomization group only)
Endpoint(s): Dose Escalation: • ORR, DCR, Best Overall Response (BOR), Progression-free survival (PFS) and Duration of Response (DOR) per RECIST 1.1; and Overall Survival (OS), Dose Escalation: • Plasma or serum concentration vs time profiles and derived PK parameters (i.e. AUC, Cmax, Cmin, Tmax, half-life) of JDQ443 and its metabolite HZC320, TNO155 and tislelizumab., Dose Escalation: • Antidrug antibody (ADA) incidence by treatment, Dose Expansion: - ORR, DCR, BOR, PFS, and DOR per RECIST 1.1; and OS, Dose Expansion: - IDCR, BOIR, IPFS and DOIR per mRANO-BM (brain metastasis group only), Dose Expansion: - Safety: Incidence and severity of dose limiting toxicities (DLTs) during the first cycle of monotherapy or combination treatment. Incidence and severity of AEs and SAEs, including changes in laboratory values, ECGs, and vital signs by treatment, Dose Expansion: - Tolerability: Frequency of dose interruptions, reductions, and dose intensity, by treatment, Dose Expansion: - Plasma or serum concentration vs time profiles and derived PK parameters (i.e. AUC, Cmax, Cmin, Tmax, half-life) of JDQ443 and its metabolite HZC320, TNO155, and tislelizumab, Dose Expansion: - Incidence of anti-tislelizumab antibodies by treatment

Source: https://euclinicaltrials.eu/ctis-public/view/2023-508073-87-00